EU clinical trial 2025-523984-39-00: A Phase 2, Open Label, Multicenter, Randomized Study, to Evaluate the Efficacy and Safety of Denikitug Monotherapy and Denikitug-based Combinations in Participants With Advanced Microsatellite Stable (MSS) Colorectal Cancer (CRC).
Protocol code: GS-US-741-7756
Sponsor: Gilead Sciences Inc. (Pharmaceutical company). Phase: Therapeutic exploratory (Phase II). Countries: Spain (authorised, recruitment pending), Italy (authorised, recruitment pending), France (authorised, recruitment pending).
Therapeutic area(s): Diseases [C] - Neoplasms [C04]
Gender: Female, Male. Age: 18-64 years, 65+ years. Enrolment: 94.
Status: Authorised, recruitment pending. Decision date: 2026-06-08. Results received: No. Last updated: 2026-06-12.
Decision dates by country: FR: 2026-06-12, IT: 2026-06-09, ES: 2026-06-08

Condition(s): Advanced Microsatellite Stable (MSS) Colorectal Cancer (CRC)
Product: GS-1811 150 mg/vial concentrate for solution for infusion, Lonsurf 15 mg/6.14 mg film-coated tablets, Avastin 25 mg/ml concentrate for solution for infusion., OPDIVO 10 mg/mL concentrate for solution for infusion., GS-1811 , Lonsurf 15 mg/6.14 mg film-coated tablets, Avastin 25 mg/ml concentrate for solution for infusion., OPDIVO 10 mg/mL concentrate for solution for infusion., Lonsurf 15 mg/6.14 mg film-coated tablets, OPDIVO 10 mg/mL concentrate for solution for infusion., OPDIVO 10 mg/mL concentrate for solution for infusion.

Primary endpoint: ORR is defined as the percentage of participants who have achieved complete response (CR) or partial response (PR) as assessed by the investigator according to RECIST Version 1.1.
Endpoint(s): DOR is measured from the time of first response (CR or PR) as assessed by investigator, per RECIST Version 1.1 until the date of first documented progressive disease (PD) or death, whichever comes first., PFS is the time from date of randomization until PD or death from any cause, whichever comes first as assessed by the investigator according to RECIST Version 1.1., OS is length of time from randomization until the date of death from any cause., The incidence, severity, seriousness, and relatedness of treatment-emergent adverse events (TEAEs) and incidence and severity of clinical laboratory abnormalities graded according to National Cancer Institute (NCI)-Common Terminology Criteria for Adverse Events (CTCAE) Version 5.0., Serum concentration of DEN and estimated PK parameters (eg, Cmax and AUCall), Percentage of treatment-emergent DEN ADA positive and ADA negative participants

Source: https://euclinicaltrials.eu/ctis-public/view/2025-523984-39-00